EU clinical trial 2024-518243-38-00: Skeletal muscle-derived cell implantation for the treatment of fecal incontinence: a phase III, randomized, controlled, double blind, two-armed clinical study.
Protocol code: IC-01-02-5-009
Sponsor: Innovacell GmbH (Pharmaceutical company). Phase: Therapeutic confirmatory (Phase III). Countries: Germany (ongoing, recruiting), Bulgaria (ongoing, recruiting), Spain (ongoing, recruiting), Poland (ongoing, recruiting), Sweden (ongoing, recruiting), Austria (ongoing, recruiting), Czechia (ongoing, recruiting), France (ongoing, recruiting), Italy (ongoing, recruiting), Slovenia (authorised, recruiting).
Therapeutic area(s): Diseases [C] - Musculoskeletal Diseases [C05]
Gender: Female, Male. Age: 18-64 years, 65+ years. Enrolment: 226.
Start date (EU): 2022-04-20. Decision date: 2025-01-30. Results received: No. Last updated: 2026-07-29.
Decision dates by country: BG: 2025-01-31, SE: 2025-01-30, ES: 2025-03-27, DE: 2025-01-30, CZ: 2025-03-07, IT: 2025-03-07, FR: 2025-03-07, AT: 2025-01-30, SI: 2025-09-03, PL: 2025-01-31

Condition(s): Fecal incontinence in female and male patients
Product: PLACEBO, ICEF15

Primary endpoint: Changes in frequency of incontinence episodes as measured by the bowel diary records prior to Visit 8 (target day 457) compared to the baseline period from diary records prior to implantation Visit 3 (target day 92), in both treatment groups.
Endpoint(s): Frequency of response measured in both treatment arms as a reduction of the frequency of incontinence episodes by ≥ 50% under treatment. Derived from diary records prior to Visit 8 (target day 457) compared to the baseline period from diary records prior to implantation Visit 3 (target day 92).

Source: https://euclinicaltrials.eu/ctis-public/view/2024-518243-38-00